EU clinical trial 2024-518452-23-00: A phase III, randomized, controlled, open label, no profit, single-center intervention study to compare the effect of a conservative (antithyroid drugs) and an ablative approach (radioiodine or total thyroidectomy) for the treatment of hyperthyroidism in patients with Graves’ disease and moderate-to-severe and active Graves’ Orbitopathy (GO) treated with intravenous glucocorticoids (ABLAGO Study)
Sponsor: Azienda Ospedaliero Universitaria Pisana (Hospital/Clinic/Other health care facility). Phase: Therapeutic confirmatory (Phase III). Countries: Italy (authorised, recruitment pending).
Therapeutic area(s): Diseases [C] - Hormonal diseases [C19]
Gender: Female, Male. Age: 18-64 years, 65+ years. Enrolment: 52.
Status: Authorised, recruitment pending. Decision date: 2024-11-19. Results received: No. Last updated: 2024-11-19.

Condition(s): Graves' disease and Graves' orbitophaty
Product: Sodio ioduro (I131) Curium Netherlands 37-7400 MBq capsula rigida, TAPAZOLE 5 mg compresse

Primary endpoint: Response rate 24 weeks after inclusion: -Comparison of overall GO outcome determined using a composite evaluation as indicated below. The evaluation will be performed by a unblinded ophthalmologist and will be documented in the CRF, including the following items: -Lid aperture in mm - CAS (5 items) -Exophthalmos in mm using a Hertel exophthalmometer -Eye ductions -Visual acuity using the Snellen chart in log10

Source: https://euclinicaltrials.eu/ctis-public/view/2024-518452-23-00